EU clinical trial 2022-501677-39-00: A Prospective, Open-label, Multicenter, Randomized Study to Evaluate the Benefits and Risks of Conversion of Existing Adolescent Renal Allograft Recipients Aged 12 to Less Than 18 Years of Age to a Belatacept-based Immunosuppressive Regimen as Compared to Continuation of a Calcineurin Inhibitor-based Regimen, and Their Adherence to Immunosuppressive Medications
Protocol code: IM103402
Sponsor: Bristol-Myers Squibb Services Unlimited Company (Pharmaceutical company). Phase: Therapeutic confirmatory (Phase III). Countries: Netherlands (ongoing, recruiting), Spain (ended), Germany (ongoing, recruiting), Belgium (ongoing, recruiting), France (ongoing, recruiting), Italy (ongoing, recruiting).
Therapeutic area(s): Diseases [C] - Immune System Diseases [C20]
Gender: Female, Male. Age: 0-17 years. Enrolment: 50.
Start date (EU): 2021-05-25. Decision date: 2023-02-08. Results received: No. Last updated: 2026-02-06.
Decision dates by country: ES: 2023-03-10, BE: 2023-03-21, NL: 2023-02-08, FR: 2023-04-11, IT: 2024-02-19, DE: 2023-02-13

Condition(s): Adolescent Renal Allografts
Product: CICLOSPORIN, TACROLIMUS, TACROLIMUS, belatacept

Primary endpoint: Proportion of participants who survive with a functional graft with an eGFR > 30 mL/min/1.73 m2 (updated Schwartz formula), 24 months post-randomization.

Source: https://euclinicaltrials.eu/ctis-public/view/2022-501677-39-00